EU clinical trial 2024-512846-41-00: A study on the safety of and immune response to different doses of an mRNA vaccine against RSV in healthy adults.
Protocol code: 222261
Sponsor: GlaxoSmithKline Biologicals (Pharmaceutical company). Phase: Human Pharmacology (Phase I)- First administration to humans. Countries: Spain (ended).
Therapeutic area(s): Diseases [C] - Respiratory Tract Diseases [C08]; Diseases [C] - Virus Diseases [C02]
Gender: Female, Male. Age: 18-64 years. Enrolment: 63.
Status: Ended. Start date (EU): 2024-11-12. End date (EU): 2026-02-17. End date: 2026-04-14. Decision date: 2024-10-31. Results received: No. Last updated: 2026-02-05.

Condition(s): Respiratory Syncytial Virus Infections

Source: https://euclinicaltrials.eu/ctis-public/view/2024-512846-41-00